EU clinical trial 2022-501800-92-00: Menthacarin® in the treatment of functional gastrointestinal disorders
Protocol code: D.02.01.2.02
Sponsor: Dr. Willmar Schwabe GmbH & Co. KG (Pharmaceutical company). Phase: Therapeutic use (Phase IV). Countries: Germany (ended).
Therapeutic area(s): Diseases [C] - Digestive System Diseases [C06]
Gender: Female, Male. Age: 18-64 years, 65+ years. Enrolment: 70.
Status: Ended. Start date (EU): 2023-05-15. End date (EU): 2023-12-21. End date: 2024-01-17. Decision date: 2023-03-30. Results received: Yes. Last updated: 2023-04-05.

Condition(s): functional gastrointestinal disorders
Product: Carmenthin bei Verdauungsstörungen

Primary endpoint: Symptom rating by the patient using 11-point numeric rating scales,, The sum of patient symptom rating of all abdominal symptoms,, Global question on symptom impact,, Most bothersome abdominal symptom,, Stool frequency via Frequency of Spontaneous Bowel Movements (SBMs),, Stool consistency via Bristol Stool Scale,, Satisfaction with change in bowel habits,, Global assessment of effectiveness, on a 5-point Likert scale, Patient´s satisfaction using the Integrative Medicine Patient Satisfaction Scale (IMPSS),, Quality of Life Questionnaire (SF 12),, Patient’s willingness to recommend Menthacarin,, Serum parameters: Zonulin and Intestinal-fatty acid binding protein (I-FABP), Adverse events, Global assessment of tolerability on a 5-point Likert scale
Endpoint(s): Due to the character of the trial, no differentiation in primary and secondary outcome variables is intended

Source: https://euclinicaltrials.eu/ctis-public/view/2022-501800-92-00